EU clinical trial 2025-521289-88-02: Pharmacokinetics and pharmacodynamics of intravenous versus enteral amiodarone in critically ill patients with new-onset atrial fibrillation – a randomised controlled pilot trial
Protocol code: 2025-521289-88-00
Sponsor: Aalborg University Hospital (Hospital/Clinic/Other health care facility). Phase: Therapeutic use (Phase IV). Countries: Denmark (ongoing, recruiting).
Therapeutic area(s): Analytical, Diagnostic and Therapeutic Techniques and Equipment [E] - Investigative Techniques [E05]; Diseases [C] - Cardiovascular Diseases [C14]
Gender: Female, Male. Age: 18-64 years, 65+ years. Enrolment: 50.
Status: Ongoing, recruiting. Start date (EU): 2025-09-01. Decision date: 2025-06-06. Results received: No. Last updated: 2026-05-28.

Condition(s): New-onset atrial fibrillation
Product: Amiodarone Hydrochloride 50 mg/ml Concentrate for Solution for Injection/Infusion, Cordan, tabletter

Primary endpoint: Pharmacokinetic of amiodarone
Endpoint(s): Pharmacodynamics of amiodarone

Source: https://euclinicaltrials.eu/ctis-public/view/2025-521289-88-02